EU clinical trial 2024-511492-15-00: A Randomized, Double-Blind, Dose Finding and Comparison Study of the Safety and Efficacy of High Doses of Eteplirsen, Preceded by an Open-Label Dose Escalation, in Patients with Duchenne Muscular Dystrophy With Deletion Mutations Amenable to Exon 51 Skipping
Protocol code: 4658-402
Sponsor: Sarepta Therapeutics Inc. (Pharmaceutical company). Phase: Therapeutic confirmatory (Phase III). Countries: Italy (ended), Denmark (ended), Czechia (ended), Norway (ongoing, recruitment ended), Hungary (ended), Netherlands (ended), Spain (ended), France (ended), Germany (ongoing, recruitment ended), Greece (ended), Slovenia (ended), Poland (ended), Romania (ended).
Therapeutic area(s): Diseases [C] - Musculoskeletal Diseases [C05]; Diseases [C] - Congenital, Hereditary, and Neonatal Diseases and Abnormalities [C16]
Gender: Male. Age: 0-17 years. Enrolment: 37.
Start date (EU): 2021-12-09. Decision date: 2024-11-04. Results received: No. Last updated: 2026-06-19.
Decision dates by country: GR: 2024-12-09, DE: 2024-11-04, NL: 2024-11-04, NO: 2024-11-05, HU: 2024-11-05, DK: 2024-11-04, PL: 2024-11-05, ES: 2024-11-04, SI: 2024-11-08, FR: 2024-11-13, IT: 2024-11-25, CZ: 2024-11-05, RO: 2024-11-06

Condition(s): Duchenne Muscular Dystrophy
Product: ETEPLIRSEN (AVI-4658)

Primary endpoint: Open-Label Dose Escalation: Incidence of AEs, Incidence of adverse events of special interest (AESIs), Abnormal changes from Baseline or worsening of vitals or physical examination findings, Incidence of SAEs, Safety laboratory assessments, Electrocardiograms (ECGs) and Echocardiograms (ECHO)., Double-Blind Dose Finding and Dose Comparison Part: -Change from Baseline at Week 72 or Week 96 in NSAA total score (for conditional efficacy interim analysis) -Change from Baseline at Week 144 in NSAA total score (for final analysis)
Endpoint(s): • Change from Baseline at Week 144 in o Time to rise (TTRISE) from floor o 10-meter walk/run time o 6-minute walk test (6MWT) o Timed 4-step stair ascend test o Forced vital capacity percent predicted (FVC%p), • Time to Loss of Ambulation (LOA) through Week 144, • Change from Baseline at Week 24, Week 48, or Week 144 in skeletal muscle dystrophin expression by: o Western blot (quantitation) o Immunohistochemistry (IHC) fiber intensity by Immunofluorescence o Exon skipping quantitation by droplet digital polymerase chain reaction (ddPCR) o Percent dystrophin-positive fibers (PDPF) by Immunofluorescence, PK parameters (plasma and muscle biopsy), • Incidence of AEs • Incidence of AESIs • Incidence of SAEs • Safety laboratory assessments, • ECGs • ECHO • Abnormal changes from Baseline or worsening of vital signs and physical examination findings

Source: https://euclinicaltrials.eu/ctis-public/view/2024-511492-15-00